EU clinical trial 2023-505821-15-00: MK-3508 Multiple Ascending Dose Study in Healthy Participants
Protocol code: MK-3508-002
Sponsor: Merck Sharp & Dohme LLC (Pharmaceutical company). Phase: Human Pharmacology (Phase I)- Other. Countries: Belgium (ended).
Therapeutic area(s): Diseases [C] - Virus Diseases [C02]
Gender: Female, Male. Age: 18-64 years. Enrolment: 24.
Status: Ended. Start date (EU): 2023-10-12. End date (EU): 2024-04-13. End date: 2024-04-14. Decision date: 2023-09-19. Results received: No. Last updated: 2023-10-12.

Condition(s): Respiratory syncytial virus infection

Source: https://euclinicaltrials.eu/ctis-public/view/2023-505821-15-00